EU clinical trial 2023-508476-11-00: A Phase 1, multicenter, open-label study of REM-422, a MYB mRNA degrader, in patients with recurrent or metastatic, adenoid cystic carcinoma.
Protocol code: REM-422-101
Sponsor: Remix Therapeutics Inc. (Pharmaceutical company). Phase: Human Pharmacology (Phase I)- First administration to humans. Countries: France (ongoing, recruiting).
Therapeutic area(s): Diseases [C] - Neoplasms [C04]
Gender: Female, Male. Age: 18-64 years, 65+ years. Enrolment: 30.
Status: Ongoing, recruiting. Start date (EU): 2026-06-05. Decision date: 2024-05-06. Results received: No. Last updated: 2026-07-03.

Condition(s): Adenoid cystic carcinoma (ACC)

Source: https://euclinicaltrials.eu/ctis-public/view/2023-508476-11-00